EU clinical trial 2023-507260-40-00: A Two-Part Open-Label Study of REGV131-LNP1265, A CRISPR/CAS9-Based Coagulation Factor IX Gene Insertion Therapy in Participants with Hemophilia B
Protocol code: R131L1265-HEMB-2318
Sponsor: Regeneron Pharmaceuticals Inc. (Pharmaceutical company). Phase: Phase I and Phase II (Integrated)- First administration to humans. Countries: Germany (ongoing, recruiting), France (ongoing, recruiting), Italy (ongoing, recruiting), Spain (ongoing, recruiting).
Therapeutic area(s): Diseases [C] - Congenital, Hereditary, and Neonatal Diseases and Abnormalities [C16]
Gender: Male. Age: 18-64 years, 65+ years. Enrolment: 40.
Status: Ongoing, recruiting. Start date (EU): 2025-06-16. Decision date: 2024-04-22. Results received: No. Last updated: 2026-07-22.
Decision dates by country: ES: 2024-09-30, IT: 2024-09-25, FR: 2024-09-27, DE: 2024-04-22

Condition(s): Hemophilia B
Product: LNP1265, REGV131

Primary endpoint: Part 1: Occurrence and severity of Treatment-Emergent Adverse Events (TEAEs)., Part 1: Coagulation Factor IX (FIX) functional activity measured using the chromogenic substrate assay., Part 2A: Change from baseline in FIX functional activity in plasma after REGV131-LNP1265 dosing at the recommended dose for expansion (RDE) measured using the chromogenic substrate assay., Part 2A: Annualized Bleeding Rate (ABR) following sustained FIX functional activity (post-REGV131-LNP1265 dosing) among participants receiving RDE., LTFU Period: Occurrence and severity of Serious Adverse Events (SAEs), Adverse Event of Special Interests (AESIs), and clinically meaningful Adverse Events (AEs).
Endpoint(s): Part 1: Change from baseline in FIX functional activity in plasma after REGV131-LNP1265 dosing at the RDE, measured using the chromogenic substrate assay., Part 1 and LTFU Period: ABR following sustained FIX functional activity (post-REGV131-LNP1265 dosing) among participants receiving the RDE., Part 1, Part 2A and LTFU Period: FIX functional activity in plasma over time during the study period using the chromogenic substrate assay (up to 10 years)., Part 1 and Part 2A: Annualized treated Bleeding Rate (tABR) following sustained FIX functional activity (post-REGV131-LNP1265 dosing) among participants receiving the RDE., Part 1, Part 2A and LTFU Period: Annualized utilization (IU/kg/year) of FIX replacement therapy following sustained FIX functional activity ( post-REGV131-LNP1265 dosing) among participants receiving the RDE., Part 1 and Part 2A: Remaining free of FIX replacement therapy among those receiving the RDE following sustained FIX expression (post-REGV131-LNP1265 dosing)., Part 1 and Part 2A: Remaining zero spontaneous bleeding events among those receiving the RDE over sustained FIX functional activity period.IX functional activity period (post-REGV131-LNP1265 dosing)., Part 1 and Part 2A: Concentrations of REGV131 components., Part 1 and Part 2A: Concentrations of LNP1265 components., Part 1 and Part 2A: Detection of antibodies to the Coagulation Factor IX gene (F9) transgene product FIX protein., Part 1 and Part 2A: Detection of Total binding Antibodies (TAbs) to the Adeno-Associated Virus 8 (AAV8) capsid proteins., Part 1 and Part 2A: Detection of Neutralizing Antibodies/Transduction Inhibitors (NAb/TI) to the AAV8 capsid proteins., Part 1 and Part 2A: Detection of antibodies to LNP1265., Part 1 and Part 2A: Detection of antibodies to CRISPR-associated protein 9 (Cas9) protein., Part 1: Detection of vector DeoxyriboNucleic Acid (DNA) in blood, saliva, nasal secretions, semen, urine, and feces over time (Part 1 dose confirmation cohort only), Part 2A: Occurrence and severity of TEAEs., Part 2A: Detection of vector DNA in relevant matrices based on data analysis of Part 1 Dose Confirmation Cohort., LTFU Period: Proportion of participants with zero spontaneous bleeding events following sustained FIX functional activity among those receiving RDE., LTFU Period: Proportion of participants not requiring FIX replacement therapy following sustained FIX functional activity among those receiving RDE.

Source: https://euclinicaltrials.eu/ctis-public/view/2023-507260-40-00